EU clinical trial 2024-515194-10-00: One multicenter, randomized, open, phase III clinical study on SHR3680 combined with androgen deprived therapy (ADT) versus Bicalutamide combined with ADT in treatment of metastatic hormone-sensitive prostate cancer with high tumor load.
Protocol code: SHR-3680-III-HSPC
Sponsor: Jiangsu Hengrui Pharmaceuticals Co. Ltd. (Pharmaceutical company). Phase: Therapeutic confirmatory (Phase III). Countries: Czechia (authorised, recruitment pending), Bulgaria (authorised, recruitment pending), Poland (authorised, recruitment pending).
Therapeutic area(s): Diseases [C] - Neoplasms [C04]
Gender: Male. Age: 18-64 years, 65+ years. Enrolment: 63.
Status: Authorised, recruitment pending. Decision date: 2024-11-26. Results received: No. Last updated: 2026-04-22.
Decision dates by country: PL: 2024-12-09, CZ: 2024-11-26, BG: 2024-12-03

Condition(s): Metastatic hormone-sensitive prostate cancer with high tumor load
Product: Casodex 50 mg Film-coated Tablets, Zoladex 10,8 mg implantat

Primary endpoint: rPFS,OS
Endpoint(s): Time to PSA progression., Time to the next bone related event (including fracture, spinal compression, radiotherapy or surgery for bones)., Time to the start of the next anti-prostate cancer treatment., ORR, Safety endpoint.

Source: https://euclinicaltrials.eu/ctis-public/view/2024-515194-10-00